EU clinical trial 2024-516055-41-00: The role of serotonin in learning and decision-making: a behavioural study
Sponsor: Radboud Universiteit Nijmegen (Educational Institution). Phase: Therapeutic use (Phase IV). Countries: Netherlands (ended).
Therapeutic area(s): Psychiatry and Psychology [F] - Behavior and Behavior Mechanisms [F01]
Gender: Female, Male. Age: 18-64 years. Enrolment: 90.
Status: Ended. Start date (EU): 2025-03-06. End date (EU): 2026-02-12. Decision date: 2024-10-22. Results received: No. Last updated: 2025-02-19.

Product: The placebo capsule will contain microcrystalline cellulose., Escitalopram Sandoz 10 mg, filmomhulde tabletten

Primary endpoint: Behavioural performance (accuracy, reaction times) on the resource investment task
Endpoint(s): Responses to a series of questionnaires that quantify individual characteristics, Behavioural performance (accuracy, reaction times) on 4 behavioural tasks

Source: https://euclinicaltrials.eu/ctis-public/view/2024-516055-41-00